EU clinical trial 2025-523912-35-00: A Phase 3, Randomized, Double-Blind, Placebo-Controlled Study to Evaluate the Efficacy and Safety of ALKS 2680 in Adults With Narcolepsy Type 2
Protocol code: ALKS 2680-303
Sponsor: Alkermes Inc. (Pharmaceutical company). Phase: Therapeutic confirmatory (Phase III). Countries: Spain (authorised, recruitment pending), Netherlands (authorised, recruitment pending), Belgium (authorised, recruitment pending), Italy (authorised, recruitment pending), France (authorised, recruitment pending).
Therapeutic area(s): Diseases [C] - Nervous System Diseases [C10]
Gender: Female, Male. Age: 18-64 years, 65+ years. Enrolment: 98.
Status: Authorised, recruitment pending. Decision date: 2026-06-04. Results received: No. Last updated: 2026-06-12.
Decision dates by country: BE: 2026-06-05, FR: 2026-06-09, IT: 2026-06-05, ES: 2026-06-12, NL: 2026-06-04

Condition(s): Narcolepsy Type 2
Product: ALKS 2680, Placebo to match ALKS 2680, ALKS 2680, ALKS 2680

Primary endpoint: Change in Epworth Sleepiness Scale from baseline to Week 12 by dose level
Endpoint(s): Change in mean sleep latency on Maintenance of Wakefulness Test from baseline to Week 12 by dose level, Change in select patient-reported outcome measures from baseline to Week 12 by dose level.

Source: https://euclinicaltrials.eu/ctis-public/view/2025-523912-35-00